EU clinical trial 2024-516936-93-02: Soothing Pain After ChEmotherapy: Psilocybin As INtervention (SPACE-PAIN) — a randomized controlled pilot trial
Sponsor: Amsterdam UMC (Hospital/Clinic/Other health care facility). Phase: Therapeutic exploratory (Phase II). Countries: Netherlands (ongoing, recruiting).
Therapeutic area(s): Analytical, Diagnostic and Therapeutic Techniques and Equipment [E] - Therapeutics [E02]; Analytical, Diagnostic and Therapeutic Techniques and Equipment [E] - Anesthesia and Analgesia [E03]; Diseases [C] - Nervous System Diseases [C10]
Gender: Female, Male. Age: 18-64 years, 65+ years. Enrolment: 50.
Status: Ongoing, recruiting. Start date (EU): 2025-10-28. Decision date: 2024-12-16. Results received: No. Last updated: 2025-01-30.
Decision dates by country: NL: 2025-01-08

Condition(s): chemotherapy-induced peripheral neuropathy, chronic neuropathic pain
Product: Oxazepam Teva 10 mg, tabletten, PEX010 Psilocybin Capsules (1mg psilocybin), PEX010 Psilocybin Capsules (25mg psilocybin)

Primary endpoint: Patient recruitment and retention rates, and completeness of outcome data. We will also assess which factors impact participation. Based on this, barriers to recruitment can be identified and addressed., Patient expectancy, measured with the 6-item Dutch Stanford Expectations of Treatment Scale (SETS)., Assessment of mystical experience, measured with the 30-item Mystical Experience Questionnaire (MEQ)., Assessment of emotional breakthrough, measured with the 6-item Emotional Breakthrough Inventory (EBI)., Assessment of psychological insight, measured with the 7-item Psychological Insight Scale (PIS)., Blinding success., Adverse events, reported by patient or observed by study staff.
Endpoint(s): Pain interference, measured with the 8-item PROMIS Pain Interference Short Form v1.1 8a., Current pain intensity, measured with the single-item Numeric Rating Scale (NRS)., Average pain intensity in the last 24 hours, measured with the single-item Numeric Rating Scale (NRS)., Pain catastrophizing, measured with the 13-item Pain Catastrophizing Scale (PCS)., Current pain medication use, including opioids in morphine-equivalents. Extracted from the electronic health record or collected via interview., Physical function, measured with the 6-item PROMIS Physical Function Short Form v2.0 6b., Sleep disturbance, measured with the 6-item PROMIS Sleep Disturbance Short Form v1.0 6a., Depression, measured with the 6-item PROMIS Depression Short Form v1.0 6a., Anxiety, measured with the 6-item PROMIS Anxiety Short Form v1.0 6a., Fatigue, measured with the 6-item PROMIS Fatigue Short Form v1.0 6a., Satisfaction with social roles, measured with the 6-item PROMIS Satisfaction with Social Roles Short Form v2.0 6a., CIPN-related quality of life, measured with the 20-item EORTC-QLQ-CIPN20., Cancer-related quality of life, measured with the 30-item EORTC-QLQ-C30., Health-related quality of life, measured with the 5-item EQ5D., Global perceived effect, measured with the 2-item Global Perceived Effect (GPE).

Source: https://euclinicaltrials.eu/ctis-public/view/2024-516936-93-02